EU clinical trial 2024-513420-41-00: Randomized, Double-Blind, Parallel-Group, Adaptive, Three-arm, Phase 2b/3 Multicenter Study to Evaluate the Efficacy and Safety of Zelpultide Alfa in Preventing Bronchopulmonary Dysplasia (BPD) in High-Risk Preterm Neonates Compared to Standard of Care (SOC)
Protocol code: ZEL-003
Sponsor: Airway Therapeutics Inc., Airway Therapeutics Spain S.L. (Pharmaceutical company). Phase: Phase II and Phase III (Integrated). Countries: Italy (ongoing, recruiting), Spain (ongoing, recruiting), Belgium (authorised, recruitment pending), France (ongoing, recruiting), Germany (authorised, recruitment pending), Poland (ongoing, recruiting), Czechia (authorised, recruitment pending), Portugal (authorised, recruitment pending).
Therapeutic area(s): Not possible to specify
Gender: Female, Male. Age: 0-17 years. Enrolment: 276.
Start date (EU): 2025-01-09. Decision date: 2024-09-30. Results received: No. Last updated: 2026-08-07.
Decision dates by country: FR: 2026-02-24, CZ: 2026-06-30, BE: 2026-02-04, PT: 2026-06-15, DE: 2026-02-11, PL: 2026-03-23, ES: 2024-10-03, IT: 2024-09-30

Condition(s): prematurity in neonates
Product: zelpultide alfa, Endotracheopulmonary instillation, room air

Primary endpoint: Part 1 (Phase 2b / Dose Selection): Incidence of grade 2 or grade 3 BPD or death at week 36 PMA, analyzed descriptively and used for the pre-specified futility assessment., Part 2 (Phase 3 / Confirmatory Phase): Incidence of grade 2 or grade 3 BPD or death at week 36 PMA.
Endpoint(s): Part 1 (Phase 2b / Dose Selection): Key Secondary Endpoints: Ventilator-free days from birth to week 36 PMA; Incidence of grade 2 or grade 3 BPD or death assessed at 3 consecutive days at week 36 PMA, Additional Efficacy Secondary Endpoints: Incidence of grade 2 or grade 3 BPD at week 36 PMA; Incidence of death at week 36 PMA; The proportion of subjects with no BPD, grade 1, grade 2, or grade 3 BPD at week 36 PMA; The proportion of subjects with no BPD, grade 1, grade 2, or grade 3 BPD assessed at 3 consecutive days at week 36 PMA., Part 2 (Phase 3 / Confirmatory Phase): Key Efficacy Secondary Endpoints: Ventilator-free days from birth to week 36 PMA; Incidence of grade 2 or grade 3 BPD at week 36 PMA; Incidence of death at week 36 PMA; Incidence of grade 2 or grade 3 BPD or death assessed at 3 consecutive days at week 36 PMA.

Source: https://euclinicaltrials.eu/ctis-public/view/2024-513420-41-00